EU clinical trial 2024-517937-41-00: Durvalumab (MEDI4736) in combination with consolidative radiochemotherapy and ablative stereotactic radiotherapy in extensive stage SCLC
Protocol code: DuCoRa-SCLC
Sponsor: Universitaet Des Saarlandes (Educational Institution). Phase: Therapeutic exploratory (Phase II). Countries: Germany (authorised, recruitment pending).
Therapeutic area(s): Diseases [C] - Neoplasms [C04]
Gender: Female, Male. Age: 18-64 years, 65+ years. Enrolment: 43.
Status: Authorised, recruitment pending. Decision date: 2024-10-29. Results received: No. Last updated: 2025-10-06.

Condition(s): extensive stage small cell lung cancer (SCLC)
Product: IMFINZI 50 mg/mL concentrate for solution for infusion., Carbomedac 10 mg/ml Konzentrat zur Herstellung einer Infusionslösung, Eto-GRY® 20 mg/ml Konzentrat zur Herstellung einer Infusionslösung, Cisplatin NeoCorp 1 mg/ml - Konzentrat zur Herstellung einer Infusionslösung

Primary endpoint: One-year progression-free survival (PFS) rate using investigator assessments according to RECIST 1.1

Source: https://euclinicaltrials.eu/ctis-public/view/2024-517937-41-00